EU clinical trial 2025-523677-41-00: (21174) Relative bioavailability study to investigate the pharmacokinetics of a single oral dose of asundexian administered as 50 mg pediatric formulation in comparison to 50 mg tablet (adult formulation) in fasted state and to investigate the effect of a high-fat, high-calorie meal on the 50 mg pediatric formulation in healthy adult participants
Protocol code: 21174
Sponsor: Bayer AG (Pharmaceutical company). Phase: Human Pharmacology (Phase I)- Other. Countries: Germany (ongoing, recruitment ended).
Therapeutic area(s): Diseases [C] - Cardiovascular Diseases [C14]
Gender: Female, Male. Age: 18-64 years. Enrolment: 18.
Status: Ongoing, recruitment ended. Start date (EU): 2026-05-06. Decision date: 2026-03-06. Results received: No. Last updated: 2026-03-09.

Condition(s): Prevention of thromboembolic events
Product: Asundexian Bayer 10mg Granules, BAY 2433334

Primary endpoint: Cmax, AUC and AUC(0-tlast) for asundexian after a single oral dose of 50 mg pediatric formulation compared to the 50 mg tablet in the fasted state, Cmax, AUC and AUC(0-tlast) for asundexian after a single oral dose of 50 mg pediatric formulation after a high-fat meal relative to the fasted state
Endpoint(s): Number of participants who experienced serious and non-serious TEAEs after administration of 50 mg asundexian as pediatric formulation and as table in the fasted state, Number of participants who experienced serious and non-serious TEAEs after administration of 50 mg asundexian as pediatric formulation in the fed state

Source: https://euclinicaltrials.eu/ctis-public/view/2025-523677-41-00